EU clinical trial 2025-524682-24-00: A Phase 2 Randomized, Double-Blind, Placebo-Controlled Study to Confirm Efficacy and Safety of MH002 and to Assess the Effect of Dose in Patients With Mild-to-Moderate Ulcerative Colitis Insufficiently Controlled With 5-Aminosalicylic Acid
Protocol code: MH002-UC-202
Sponsor: Microbial Resource Management Health (Pharmaceutical company). Phase: Therapeutic exploratory (Phase II). Countries: Czechia (authorised, recruitment pending), Poland (authorised, recruitment pending), Italy (authorised, recruitment pending).
Therapeutic area(s): Diseases [C] - Digestive System Diseases [C06]
Gender: Female, Male. Age: 0-17 years, 18-64 years, 65+ years. Enrolment: 109.
Status: Authorised, recruitment pending. Decision date: 2026-07-16. Results received: No. Last updated: 2026-07-20.
Decision dates by country: CZ: 2026-07-16, IT: 2026-07-17, PL: 2026-07-20

Condition(s): Ulcerative Colitis
Product: MH002, Placebo to match MH002 oral capsule, MH002

Primary endpoint: Change from baseline in centrally-assessed Mayo endoscopic subscore (MES) at Week 12
Endpoint(s): 1. Clinical remission at Week 12, defined as a modified Mayo Score (mMS) ≤2, all mMS subscores ≤1, and a Rectal Bleeding (RB) subscore of 0, and an SF subscore not greater than baseline, with endoscopic MES based on worst segment assessed by a blinded central reader, and 2-item Patient-Reported Outcome (PRO-2) scores computed from the e-diary data, 2. Change from baseline in histologic scores at Week 12 (Robarts’ Histopathology Index [RHI]), 3. (Median) Percent change from baseline in fecal calprotectin (FC) at Week 12, 4. Change from baseline in UC-100 score at Week 12, 5. Change from baseline in PRO-2 at Week 12, 6. Treatment-emergent adverse events (TEAEs) and serious adverse events (SAEs), 7. Treatment-emergent abnormalities in laboratory parameters and vital signs

Source: https://euclinicaltrials.eu/ctis-public/view/2025-524682-24-00